EU clinical trial 2024-513952-13-00: A Phase IIIB study to evaluate the use of capivasertib in combination with fulvestrant in patients with HR+ / HER2- advanced breast cancer who have relapsed/progressed on ET and CDK4/6 inhibitor reflecting Real World Clinical Practice in Spain: CAPItana Study.
Protocol code: D3612L00005
Sponsor: Astrazeneca Farmaceutica Spain S.A. (Pharmaceutical company). Phase: Therapeutic confirmatory (Phase III). Countries: Spain (ongoing, recruitment ended).
Therapeutic area(s): Diseases [C] - Neoplasms [C04]
Gender: Female, Male. Age: 18-64 years, 65+ years. Enrolment: 100.
Status: Ongoing, recruitment ended. Start date (EU): 2025-01-02. Decision date: 2024-11-04. Results received: No. Last updated: 2026-07-07.

Condition(s): HR+ / HER2- advanced breast cancer
Product: TRUQAP 160 mg film-coated tablets, TRUQAP 200 mg film-coated tablets

Primary endpoint: Time to next treatment (TTNT1) is defined as the time from the date of first dose until the first subsequent anti-cancer therapy after discontinuation of study treatment or death due to any cause. The measure of interest is the median TTNT1.
Endpoint(s): • Frequency of adverse events that lead to capivasertib + fulvestrant dose changes, temporary interruptions, or permanent discontinuation. They will be described overall and according to the reason for discontinuation., Frequency of adverse events of special interest, Frequency of serious adverse events., Frequency of ≥ Grade 3 adverse events, Dosing characteristics (e.g., mean starting dose, percentage of patients with one dose reduction, percentage of patient with temporary interruptions, reasons for interruptions, median absolute and relative dose intensity)., Median treatment duration, Permanent discontinuations (frequency of reasons for discontinuation and rates at months 6, 12 and 24 after treatment initiation). Overall and by treatment line and type of endocrine resistance (primary, secondary)., Median time to the first subsequent chemotherapy (TFSC is defined as the time from the date of first dose of capivasertib + fulvestrant treatment until the first date of the first cycle of the subsequent chemotherapy, or death from any cause)., Median progression-free survival (PFS is defined as the time from the date of first dose of capivasertib + fulvestrant treatment until the date of disease progression (RECIST v1.1 by investigator assessment), or death from any cause)., Objective Response Rate (ORR) using site investigator assessments according to RECIST 1.1., Median overall survival., Change from baseline in score on EORTC QLQ-C30 and EORTC QLQ-BR23, Time to deterioration defined as the time from the date of the first dose of treatment until the date of the first clinically meaningful deterioration, Change from baseline in score on the Patient Global Impression of Symptom Severity (PGI-S), Change from baseline in score on the Patient's Global Impression of Treatment Tolerability (PGI-TT), Change from baseline in score on the Daily bowel habits diary (Bristol Stool Form Scale), Change from baseline in score on Adelphi Adherence Questionnaire (ADAQ) to assess the adherence of capivasertib + fulvestrant treatment

Source: https://euclinicaltrials.eu/ctis-public/view/2024-513952-13-00